EU clinical trial 2024-515920-35-01: Intravenous iron to treat postoperative anaemia in older cardiac surgery patients: a randomized controlled trial (AGE ANAEMIA study)
Sponsor: Sint Antonius Ziekenhuis Stichting (Hospital/Clinic/Other health care facility). Phase: Therapeutic use (Phase IV). Countries: Netherlands (ongoing, recruiting).
Therapeutic area(s): Diseases [C] - Cardiovascular Diseases [C14]
Gender: Female, Male. Age: 65+ years. Enrolment: 310.
Status: Ongoing, recruiting. Start date (EU): 2024-08-22. Decision date: 2024-08-22. Results received: No. Last updated: 2026-03-27.

Condition(s): iron deficiency anaemia
Product: Monofer 100 mg/ml oplossing voor injectie/infusie, 0.9% Sodium Chloride Intravenous Infusion Solution

Primary endpoint: Primary endpoint is disability as measured by the 12- item World Health Organization Disability Assessment score 2.0 (WHODAS-12) at POD 90 after elective cardiac surgery.
Endpoint(s): Postoperative RBC transfusions; Change in reticulocyte hemoglobin content from randomization to hospital discharge; Hb levels at hospital discharge; Hospital complications according to the Nederlandse Hart Registratie (NHR); Days alive and out of hospital at POD 90; Change in PROMs regarding dyspnoea symptoms at POD 90 (assessed with the RDS)

Source: https://euclinicaltrials.eu/ctis-public/view/2024-515920-35-01